EU clinical trial 2022-501867-42-01: International proof of concept therapeutic Stratification trial of Molecular Anomalies in Relapsed or Refractory HEMatological malignancies in children - Sub-protocol C
Protocol code: HEM-iSMART sub C
Sponsor: Princess Maxima Center For Pediatric Oncology (Hospital/Clinic/Other health care facility). Phase: Phase I and Phase II (Integrated)- Other. Countries: Denmark (authorised, recruiting), Norway (authorised, recruiting), Italy (authorised, recruitment pending), Netherlands (authorised, recruiting), Finland (authorised, recruitment pending), Spain (authorised, recruiting), Germany (authorised, recruiting), Sweden (authorised, recruiting), Austria (authorised, recruiting), France (authorised, recruitment pending), Belgium (ongoing, recruiting).
Therapeutic area(s): Diseases [C] - Hemic and Lymphatic Diseases [C15]; Diseases [C] - Neoplasms [C04]
Gender: Female, Male. Age: 0-17 years, 18-64 years. Enrolment: 20.
Start date (EU): 2025-09-08. Decision date: 2024-10-30. Results received: No. Last updated: 2026-05-04.
Decision dates by country: NL: 2024-12-03, DK: 2024-11-05, ES: 2024-10-30, DE: 2024-11-08, SE: 2024-11-06, NO: 2024-11-04, FI: 2024-12-02, AT: 2024-11-08, IT: 2024-11-05, BE: 2025-10-21, FR: 2025-11-26

Condition(s): Acute Lymphoblastic Leukemia, in Relapse Lymphoblastic Lymphoma (Precursor B-Lymphoblastic Lymphoma/Leukaemia) Recurrent Lymphoblastic Lymphoma (Precursor T-Lymphoblastic Lymphoma/Leukaemia) Recurrent Lymphoblastic Lymphoma (Precursor B-Lymphoblastic Lymphoma/Leukaemia) Refractory Lymphoblastic Lymphoma (Precursor T-Lymphoblastic Lymphoma/Leukaemia) Refractory
Product: Jakavi 5 mg tablets, Venetoclax, Jakavi 20 mg tablets, Venetoclax, Jakavi 10 mg tablets, Venetoclax, Venetoclax, Venetoclax, Venetoclax, Jakavi 15 mg tablets

Primary endpoint: Phase I: determine the maximum tolerated dose (MTD), Phase II: Best Overall Response Rate (ORR)
Endpoint(s): Overall survival (OS) is defined as time from C1D1 until death of any cause. Patients still alive at the time of clinical cut-off date will be censored at their last known date alive., Event-free survival (EFS) is defined as time from C1D1 to the first event (subsequent relapse after CR (including molecular reappearance), death of any cause, failure to achieve remission (CR, CRp or CRi), or secondary malignancy). Patients who are event-free will be censored at date of last adequate disease assessment. Treatment failure (defined by morphology and/or flow-cytometry as not achieving remission after 1 cycle) is calculated as an event at day 1., Cumulative incidence of relapse (CIR): Estimate of the risk, that a patient will develop a relapse over a specified period of time. Deaths without relapse will be considered competing events., Number of patients proceeding to HSCT after the experimental therapy: The rate of those proceeding to subsequent allogenic hematopoietic stem cell transplantation as consolidation therapy is calculated as the number of patients who receive an HSCT divided by the total number of patients enrolled., Cumulative overall response rate (ORR), defined as the CR, CRp, CRi and MRD neg-ativity rates after more than 1 cycle of treatment. The best overall response is the best response recorded from the start of the treatment until patient gets off-study or the cut-off date, whichever comes first (taking as reference for progressive disease the small-est measurements recorded since the treatment started)., Rate of dose limiting toxicities (DLTs); number of participants with dose limiting toxicities., PK parameters, including but not limited to plasma concentration time profiles, AUClast, AUCtau, Cmin, Cmax, Tmax, clearance, half-life time., QoL will be assessed at baseline and after cycle 1 and at the end of treatment using the PedsQL™ Cancer Module.

Source: https://euclinicaltrials.eu/ctis-public/view/2022-501867-42-01